EU clinical trial 2023-508462-15-00: A Long-term Extension Trial to Evaluate the Safety and Tolerability of TAK-861 in Participants With Selected Central Hypersomnia Conditions.
Protocol code: TAK-861-2003
Sponsor: Takeda Development Center Americas Inc. (Pharmaceutical company). Phase: Phase II and Phase III (Integrated). Countries: Norway (ongoing, recruitment ended), Finland (ongoing, recruitment ended), Germany (ongoing, recruiting), Italy (ongoing, recruiting), Spain (ongoing, recruiting), France (ongoing, recruiting), Sweden (ongoing, recruitment ended), Netherlands (ongoing, recruiting), Austria (ongoing, recruitment ended), Belgium (ongoing, recruitment ended), Poland (ongoing, recruitment ended).
Therapeutic area(s): Diseases [C] - Nervous System Diseases [C10]
Gender: Female, Male. Age: 18-64 years, 65+ years. Enrolment: 304.
Start date (EU): 2023-04-27. Decision date: 2024-03-27. Results received: No. Last updated: 2026-05-05.
Decision dates by country: SE: 2024-03-27, DE: 2024-04-09, AT: 2025-02-23, BE: 2025-02-11, NL: 2024-03-29, IT: 2024-04-02, NO: 2024-03-27, FR: 2024-03-27, FI: 2024-03-28, ES: 2024-03-27, PL: 2025-03-02

Condition(s): Narcolepsy with Cataplexy (Narcolepsy Type 1)
Product: TAK-861, TAK-861 placebo (same excipients as TAK-861), TAK-861

Primary endpoint: Occurrence of at least 1 treatment-emergent adverse event (TEAE).
Endpoint(s): Change from baseline in the parent study in MWT mean sleep latency., Change from baseline in the parent study in ESS total score, Change from baseline in the parent study in WCR using the patient reported Cataplexy Diary

Source: https://euclinicaltrials.eu/ctis-public/view/2023-508462-15-00